EU clinical trial 2024-515794-99-00: Effect of Alpha-1 Antitrypsin Supplementation in Alcohol-Associated Hepatitis-A prospective Pilot Study
Protocol code: EARTH
Sponsor: Medizinische Universitaet Innsbruck (Educational Institution). Phase: Therapeutic exploratory (Phase II). Countries: Austria (ongoing, recruiting).
Therapeutic area(s): Diseases [C] - Pathological Conditions, Signs and Symptoms [C23]
Gender: Female, Male. Age: 18-64 years, 65+ years. Enrolment: 16.
Status: Ongoing, recruiting. Start date (EU): 2025-06-18. Decision date: 2025-01-15. Results received: No. Last updated: 2026-07-09.

Condition(s): Alcohol-Associated Hepatitis
Product: Prednisolon "Nycomed“ 5 mg - Tabletten, Prolastin 1000 mg, Pulver und Lösungsmittel zur Her- stellung einer Infusionslösung

Primary endpoint: Serum concentration of IL-6 assessed at Visit 2 (Day 8+/-1) in the intervention (A1AT in combination with standard-of-care) and control group (standard-of-care).
Endpoint(s): The secondary endpoints are: (i) serum A1AT concentration assessed at visit 5 (Day 29+/-3); (ii) incidence of Adverse Events (AEs) from the baseline visit (Day 1) to end of study visit (Day 90+/-7); and (iii) incidence of Serious Adverse Events (SAEs) from the baseline visit (Day 1) through to end of study visit (Day 90+/-7). CLDQ-D overall and subscale scores., Exploratory endpoints: Clinical disease scores : CLDQ-D overall and subscale scores, MELD, MELD-Na, Child-Pugh-Turcotte, CLIF-C-AD, CLIF-C-OF, CLIF-SOFA score, Maddrey’s discriminant function. Clinical outcome: time to hospital discharge, time to re-hospitalization, time to ICU admission, liver-specific survival and transplant-free survival at End of Study Visit. Serum concentrations of IL-6

Source: https://euclinicaltrials.eu/ctis-public/view/2024-515794-99-00